EU clinical trial 2023-509370-39-00: An open-label study to investigate the long-term safety and efficacy of belimumab in adults with interstitial lung disease (ILD) associated with systemic sclerosis (SSc) and other connective tissue diseases (CTD)
Protocol code: 219855
Sponsor: Glaxosmithkline Research & Development Limited (Pharmaceutical company). Phase: Therapeutic confirmatory (Phase III). Countries: Greece (ongoing, recruiting), Denmark (authorised, recruitment pending), Italy (ongoing, recruiting), Finland (authorised, recruitment pending), Spain (ongoing, recruiting), France (ongoing, recruiting), Belgium (authorised, recruitment pending), Germany (ongoing, recruiting).
Therapeutic area(s): Diseases [C] - Immune System Diseases [C20]
Gender: Female, Male. Age: 18-64 years, 65+ years. Enrolment: 158.
Start date (EU): 2025-06-03. Decision date: 2025-01-16. Results received: No. Last updated: 2026-06-26.
Decision dates by country: DK: 2025-01-18, DE: 2025-01-20, FI: 2025-01-17, GR: 2025-01-16, IT: 2025-01-17, BE: 2025-01-17, FR: 2025-01-16, ES: 2025-01-16

Condition(s): connective tissue diseases
Product: Benlysta 200 mg solution for injection in pre-filled pen.

Primary endpoint: Incidence of AEs, AESIs and SAEs
Endpoint(s): Absolute change from baseline* in FVC (mL) at OLE Weeks 12, 26 and 52.

Source: https://euclinicaltrials.eu/ctis-public/view/2023-509370-39-00